EU clinical trial 2025-521416-19-00: A Phase IIb, Randomized, Double-blind, Placebo-controlled Study to Evaluate the Efficacy and Safety of AZD5148 for Prevention of Recurrence of Clostridioides difficile Infection in Individuals 18 Years of Age and Above
Protocol code: D8820C00003 PRISM
Sponsor: AstraZeneca AB (Pharmaceutical company). Phase: Therapeutic exploratory (Phase II). Countries: Greece (ongoing, recruiting), Spain (ongoing, recruiting), France (ongoing, recruiting), Germany (ongoing, recruiting), Italy (ongoing, recruiting), Hungary (ongoing, recruiting), Denmark (ongoing, recruiting), Sweden (authorised, recruiting).
Therapeutic area(s): Diseases [C] - Bacterial Infections and Mycoses [C01]
Gender: Female, Male. Age: 18-64 years, 65+ years. Enrolment: 122.
Start date (EU): 2026-03-12. Decision date: 2026-02-16. Results received: No. Last updated: 2026-05-06.
Decision dates by country: DK: 2026-02-16, FR: 2026-02-17, DE: 2026-02-17, HU: 2026-02-20, IT: 2026-02-23, GR: 2026-02-16, ES: 2026-02-23, SE: 2026-02-16

Condition(s): Recurrence of Clostridioides difficile Infection
Product: Placebo for AZD5148, AZD5148

Primary endpoint: First occurrence of recurrent C. difficile infection
Endpoint(s): Sustained clinical cure (ie, achievement of initial clinical cure + no recurrent C. difficile infection)

Source: https://euclinicaltrials.eu/ctis-public/view/2025-521416-19-00